EU clinical trial 2024-511268-10-00: Phase II clinical trial of AMG510 (Sotorasib) in stage III unresectable NSCLC KRAS p.G12C patients_MERIT-lung
Sponsor: Fundacion GECP (Patient organisation/association). Phase: Therapeutic exploratory (Phase II). Countries: Spain (ongoing, recruitment ended).
Therapeutic area(s): Diseases [C] - Neoplasms [C04]
Gender: Female, Male. Age: 18-64 years, 65+ years. Enrolment: 19.
Status: Ongoing, recruitment ended. Start date (EU): 2022-05-25. Decision date: 2024-06-18. Results received: No. Last updated: 2026-04-10.

Condition(s): Unresectable stage III (IIIA-N2, IIIB, IIIC) KRAS p.G12C non-small cell lung cancer
Product: LUMYKRAS 120 mg film-coated tablets

Primary endpoint: "Primary-PFS will be defined as the time from the date of first dose of induction treatment until the date of first objective disease progression or death. The PFS6 will be defined as the Kaplan-Meier estimate of PFS at 6 months. Progression will be evaluated according to Response Evaluation Criteria in Solid Tumors (RECIST) version 1.1"
Endpoint(s): 1. Overall response rate (ORR) is defined as the proportion of patients who have a partial or complete response to therapy; it does not include stable disease and is a direct measure of drug tumoricidal activity., 2. Overall Survival (OS) rate of live patients from enrollment until 6 months, 1 year and 2 years of treatment., 3. Sites of first failure, 4. To evaluate the safety and tolerability of AMG510 (Sotorasib), 5. To evaluate number of patients that become resectable after induction treatment

Source: https://euclinicaltrials.eu/ctis-public/view/2024-511268-10-00